EU clinical trial 2024-517820-21-00: An open-label study to evaluate the safety and tolerability of inhaled Teicoplanin in the treatment of Staphylococcus aureus (including mrsa) infections in cystic fibrosis patients
Protocol code: CRCFC-TEICO.SA.2022
Sponsor: Azienda Ospedaliera Universitaria Integrata Verona (Hospital/Clinic/Other health care facility). Phase: Therapeutic exploratory (Phase II). Countries: Italy (ongoing, recruiting).
Therapeutic area(s): Diseases [C] - Respiratory Tract Diseases [C08]
Gender: Female, Male. Age: 0-17 years, 18-64 years. Enrolment: 12.
Status: Ongoing, recruiting. Start date (EU): 2024-11-29. Decision date: 2024-10-07. Results received: No. Last updated: 2024-10-07.

Condition(s): cystic fibrosis associated to persistent Staphylococcus aureus (including MRSA) infection
Product: Teicoplanina Sandoz 200 mg polvere e solvente per soluzione iniettabile o infusione o soluzione orale

Primary endpoint: The primary endpoint of the study is the evaluation of safety and tolerability of inhaled teicoplanin. This will be measured as: a) decline from baseline of FEV1 value ≥ 20% after 30 minutes from administration; b) oxygen saturation < 90% after 30 minutes from administration; c) severe coughing; d) chest tightness; e) throat discomfort; f) moderate/severe dyspnea
Endpoint(s): Changes in bacterial load of Staphylococcus aureus in sputum as determined by CFU values at baseline (Visit 2) and at Visits 3 (after 1st treatment cycle), Visits 5 (after 2nd treatment cycle) and Visits 6 (after follow-up period), in comparison to baseline, Changes in pulmonary function tests as determined by FEV1 at baseline (Visit 2) and at each study visit until end of follow-up period, in comparison to baseline., Changes in Lung Clearance Index (LCI) measured at baseline (Visit 2) and at each study visit until end of follow-up period, in comparison to baseline, Changes in plethysmography values measured at baseline (Visit 2) and at the end of the treatment (Visit 5), Rate of persistent Staphylococcus aureus infection eradication among the patients being treated with the drug at a dosage of 200 mg/3ml BID for two cycles of 28 days separated by 28 days without treatment.

Source: https://euclinicaltrials.eu/ctis-public/view/2024-517820-21-00